EU clinical trial 2023-504515-33-00: A Phase 2 Open-label, Two-cohort Study to Evaluate Patient Preference for nivolumab + relatlimab Fixed-dose Combination Subcutaneous versus nivolumab + relatlimab Fixed-dose Combination Intravenous and nivolumab Subcutaneous versus nivolumab Intravenous in Participants with Melanoma
Protocol code: CA224-1044
Sponsor: Bristol-Myers Squibb Services Unlimited Company (Pharmaceutical company). Phase: Therapeutic exploratory (Phase II). Countries: Italy (ongoing, recruitment ended), Greece (ongoing, recruitment ended), Spain (ongoing, recruitment ended).
Therapeutic area(s): Diseases [C] - Neoplasms [C04]
Gender: Female, Male. Age: 18-64 years, 65+ years. Enrolment: 82.
Status: Ongoing, recruitment ended. Start date (EU): 2024-02-19. Decision date: 2024-01-16. Results received: No. Last updated: 2026-08-04.
Decision dates by country: ES: 2024-01-22, GR: 2024-01-22, IT: 2024-01-16

Condition(s): Melanoma
Product: FDC Nivolumab + Relatlimab + rHuPH20 Injection, Nivolumab Subcutaneous, OPDIVO 10 mg/mL concentrate for solution for infusion., Nivolumab/Relatlimab

Primary endpoint: The main endpoint in both groups is the percentage of participants who prefer having the treatment given as SC more than as IV.
Endpoint(s): The secondary endpoint in both groups is to see the side effects and abnormal laboratory tests during the study.

Source: https://euclinicaltrials.eu/ctis-public/view/2023-504515-33-00